EU clinical trial 2025-521408-24-00: Low dose corticosteroids adjacent to enzyme replacement therapy or chaperon therapy in patients with cardiac manifestation of Fabry disease – prospective randomized controlled phase III trial
Protocol code: SHIELD-FABRY/2025/1
Sponsor: Medical University Of Lodz (Educational Institution). Phase: Therapeutic confirmatory (Phase III). Countries: Poland (ongoing, recruiting).
Therapeutic area(s): Diseases [C] - Congenital, Hereditary, and Neonatal Diseases and Abnormalities [C16]; Diseases [C] - Cardiovascular Diseases [C14]
Gender: Female, Male. Age: 18-64 years, 65+ years. Enrolment: 40.
Status: Ongoing, recruiting. Start date (EU): 2026-03-05. Decision date: 2025-10-17. Results received: No. Last updated: 2026-06-10.

Condition(s): Fabry disease
Product: PREDNISONE

Primary endpoint: Reduction in high-sensitivity troponin T (hsTnT) levels by 50% at the end of GCS therapy compared to levels at the visit before starting GCS.
Endpoint(s): Combined clinical outcome (death + cardiac arrest + unplanned cardiac hospitalization), Quality of life measured by SF-36v.2; EQ-5D and KCCQ, Fabry disease progression assessed by dedicated Mainz Severity Score Index (MSSI), DS3 and FASTEX scores, Assessment of functional capacity using cardiopulmonary exercise testing (CPET), 6-minute walk test (6MWT) and NYHA classification, Electrocardiographic abnormalities (brady- and tachyarrhythmias, autonomic tension), Echocardiographic assessment (morphological and functional evaluation of the heart), Cardiac MRI abnormalities (left ventricular mass, inflammation and fibrosis), Biochemical biomarkers of the heart (CK-MB, NT-pro-BNP), Substrate levels of FD-specific biomarkers ( Gb3 in urine and Lyso-Gb3 in serum), Antidrug antibody (ADA) levels in patients on ERT, Levels of inflammatory cytokines (CRP, IL-1beta, IL-6, IL-8, IL-10, IL-12, TNF alpha, SAA), Assessment of renal function with glomerular filtration rate (eGFR), albumin/creatinine ratio (ACR), FGF2 and VEGFA

Source: https://euclinicaltrials.eu/ctis-public/view/2025-521408-24-00